EU clinical trial 2024-519129-38-00: Neoadjuvant pembrolizumab in high-risk thyroid cancers (NEPENTHE)
Sponsor: Istituti Clinici Scientifici Maugeri In Forma Abbreviata Istituti Clinici Scientifici Maugeri O Anche Ics Maugeri O Maugeri S.p.A. Sb (Hospital/Clinic/Other health care facility). Phase: Therapeutic exploratory (Phase II). Countries: Italy (ongoing, recruiting).
Therapeutic area(s): Diseases [C] - Otorhinolaryngologic Diseases [C09]
Gender: Female, Male. Age: 18-64 years. Enrolment: 25.
Status: Ongoing, recruiting. Start date (EU): 2023-10-25. Decision date: 2025-01-13. Results received: No. Last updated: 2026-05-18.

Condition(s): thyroid cancers
Product: KEYTRUDA 25 mg/mL concentrate for solution for infusion

Primary endpoint: To investigate the behavior of exhausted CD8+ T in response to pembrolizumab in TCs and the relationships between T cell clusters. To this aim, “spatial-transcriptomic” sequencing will be performed in tumor tissues and will be paired to single-cell maps at peripheral level before and after pembrolizumab.
Endpoint(s): Cancer immunotherapy aims to induce a durable human immune response in order to destroy tumour cells (Jacobson M, 2019). Biological mechanisms behind a prolonged immune response are still unknown. We hypothesize that the persistence of tumor-specific T-cell clones after the treatment of primary cancer, might contribute to a durable immune response as well as a better patients’ outcome. Single cell/spatial-transcriptomics sequencing will be applied to the blood samples collected after surgery and

Source: https://euclinicaltrials.eu/ctis-public/view/2024-519129-38-00